EU clinical trial 2023-507029-40-00: EARLY treatment with Candesartan vs Placebo in asymptomatic GENEtic carriers of Dilated Cardiomyopathy (EARLY-GENE trial)
Protocol code: EARLY-GENE
Sponsor: Fundacion Para La Investigacion Biomedica Del Hospital Universitario Puerta De Hierro Majadahonda (Hospital/Clinic/Other health care facility). Phase: Therapeutic confirmatory (Phase III). Countries: Spain (ongoing, recruiting), Netherlands (ongoing, recruiting).
Therapeutic area(s): Diseases [C] - Congenital, Hereditary, and Neonatal Diseases and Abnormalities [C16]; Diseases [C] - Cardiovascular Diseases [C14]
Gender: Female, Male. Age: 18-64 years. Enrolment: 430.
Status: Ongoing, recruiting. Start date (EU): 2022-05-09. Decision date: 2023-08-25. Results received: No. Last updated: 2026-01-20.
Decision dates by country: ES: 2023-08-25, NL: 2024-04-04

Condition(s): Genetic carriers of dilated cardiomyopathy causing variants
Product: Atacand 8, tabletten 8 mg, Candesartán Kern Pharma 8 mg comprimidos EFG, Candesartan cilexetil Teva 8 mg, tabletten, Same composition than TEST PRODUCT (16 mg candesartan) but with no active substance, Candesartán Kern Pharma 16 mg comprimidos EFG

Primary endpoint: Proportion of participants that progress to either a LVEF or LVEDV deterioration of ≥10% with respect to the baseline value at the end of follow-up as measured by MRI
Endpoint(s): Proportion of participants that progress to a LVEF deterioration of ≥10% compared to baseline value at the end of follow-up as measured by MRI, Proportion of participants that progress to a LVEDV deterioration of ≥10% compared to baseline value at the end of follow-up as measured by MRI., Changes in LVEF measured by MRI (vs baseline), Changes in LVEDV measured by MRI (vs baseline), Proportion of individuals who develop DCM (LVEF<50%), Proportion of participants in each treatment group developing Serious Adverse Events (SAEs), Grade 3-4 adverse events (AEs), Adverse Reactions, or AEs of Special Interest (AESIs), Proportion of treatment discontinuations in the candesartan and placebo groups

Source: https://euclinicaltrials.eu/ctis-public/view/2023-507029-40-00